EU clinical trial 2022-501035-16-01: COPD - Eosinophil-guided Reduction of Inhaled Corticosteroids (COPERNICOS)
Protocol code: COPERNICOS
Sponsor: Gentofte Hospital, Frederiksberg Hospital (Hospital/Clinic/Other health care facility). Phase: Therapeutic use (Phase IV). Countries: Denmark (ended).
Therapeutic area(s): Diseases [C] - Respiratory Tract Diseases [C08]
Gender: Female, Male. Age: 18-64 years, 65+ years. Enrolment: 444.
Status: Ended. Start date (EU): 2022-08-23. End date (EU): 2025-12-16. Decision date: 2022-08-23. Results received: No. Last updated: 2024-06-04.

Condition(s): Chronic obstructive pulmonary disease (COPD)
Product: Azithromycin "Sandoz", filmovertrukne tabletter, Placebo, Azithromycin ”Stada”, filmovertrukne tabletter, Azithromycin ”Jubilant”, filmovertrukne tabletter, Placebo corresponding to azithromycin jubilant 250 mg capsule

Primary endpoint: Number of hospitalization-requiring exacerbations and/or death within 365 days.
Endpoint(s): Death or “uncontrolled AECOPD tendency” within 365 days., Number of moderate/severe exacerbation within 365 days., Cumulative dose of inhaled corticosteroids within 365 days., Cumulative dose of systemic corticosteroids within 365 days., Change in lung function (ΔFEV1) from baseline to 365 days., Change in blood eosinophils from baseline to 365 days (eosinophilic trajectories)., New diagnosis of diabetes mellitus within 365 days., Change in HbA1c from baseline to 365 days., Antibiotic-requiring infections within 365 days., Difference in respiratory microbiota abundance and diversity at 12 months between treatment arms., Change in COPD-related quality of life (Based on COPD Assessment Test - CAT) from baseline to 365 days., Number who progress to MRC -dyspnea score from < 3 to ≥3 anytime during follow-up (assessed every 3 months)., Number of admission requiring NIV treatment or admissions to intensive care within 365 days., Mortality within 365 days., Difference in immunological profile including cytokines and chemokines in the upper airways from baseline to 12 months between treatment arms, “Days alive and out of hospital" within 365 days after recruitment

Source: https://euclinicaltrials.eu/ctis-public/view/2022-501035-16-01